EU clinical trial 2025-524123-45-00: Treatment of low-flow vascular malformations with bleomycin electrosclerotherapy (BEST)
Protocol code: ORI2025-46
Sponsor: Institute Of Oncology Ljubljana (Hospital/Clinic/Other health care facility). Phase: Therapeutic exploratory (Phase II). Countries: Slovenia (authorised, recruitment pending).
Therapeutic area(s): Diseases [C] - Congenital, Hereditary, and Neonatal Diseases and Abnormalities [C16]; Diseases [C] - Skin and Connective Tissue Diseases [C17]
Gender: Female, Male. Age: 18-64 years, 65+ years. Enrolment: 140.
Status: Authorised, recruitment pending. Decision date: 2026-04-07. Results received: No. Last updated: 2026-05-25.
Decision dates by country: SI: 2026-05-21

Condition(s): VASCULAR MALFORMATION
Product: Bleomycin medac, 15 000 RÜ süstelahuse pulber

Primary endpoint: To evaluate effectiveness of BEST in reducing lesion volume, as measured by MRI 3 months after the treatment in patients with low-flow vascular malformations.
Endpoint(s): Assessment of the effectiveness of BEST 12 months after the treatment., Feasibility of recruitment and treatment according to the Current Operating Procedures, Safety and tolerability: Incidence, severity and relationship of treatment-emergent adverse events classified accordint to MedDRA and graded using CTCEA v5.0, Quality of life: QoL assessment with clinically validated OVAMA questioner.

Source: https://euclinicaltrials.eu/ctis-public/view/2025-524123-45-00